EU clinical trial 2023-510356-23-00: Phase I open-label, multi-center study to evaluate the safety, tolerability, dosimetry, and preliminary activity of [177Lu]Lu-NNS309 in patients with pancreatic, lung, breast and colorectal cancers.
Protocol code: CFXX489A12101
Sponsor: Novartis Pharma AG (Pharmaceutical company). Phase: Human Pharmacology (Phase I)- First administration to humans. Countries: Italy (ongoing, recruiting), Belgium (ongoing, recruiting), Germany (ongoing, recruiting), Spain (ongoing, recruiting), France (ongoing, recruiting), Netherlands (ongoing, recruiting).
Therapeutic area(s): Diseases [C] - Neoplasms [C04]
Gender: Female, Male. Age: 18-64 years, 65+ years. Enrolment: 76.
Status: Ongoing, recruiting. Start date (EU): 2025-07-18. Decision date: 2024-12-04. Results received: No. Last updated: 2026-05-12.
Decision dates by country: ES: 2024-12-04, BE: 2024-12-05, FR: 2024-12-09, IT: 2024-12-09, NL: 2024-12-16, DE: 2024-12-06

Condition(s): Locally advanced or metastatic unresectable colorectal cancer (CRC), Locally advanced unresectable or metastatic breast cancer (BC), Locally advanced unresectable or metastatic non-small cell lung cancer (NSCLC), Locally advanced unresectable or metastatic pancreatic ductal adenocarcinoma (PDAC)

Source: https://euclinicaltrials.eu/ctis-public/view/2023-510356-23-00